EU clinical trial 2024-514711-99-00: Body surface area-based vs concentration-based dosing of cisplatin for hyperthermic intraperitoneal chemotherapy (HIPEC) in women with advanced ovarian cancer (CISCON)
Sponsor: Het Nederlands Kanker Instituut-Antoni van Leeuwenhoek Ziekenhuis Stichting (Hospital/Clinic/Other health care facility). Phase: Phase II and Phase III (Integrated). Countries: Netherlands (ongoing, recruitment ended).
Therapeutic area(s): Diseases [C] - Neoplasms [C04]
Gender: Female. Age: 18-64 years, 65+ years. Enrolment: 40.
Status: Ongoing, recruitment ended. Start date (EU): 2022-05-02. Decision date: 2024-06-13. Results received: No. Last updated: 2024-06-13.

Condition(s): FIGO stage III high grade serous ovarian cancer, peritoneal cancer, or fallopian tube carcinoma
Product: Cisplatine Accord 1 mg/ml concentraat voor oplossing voor infusie

Primary endpoint: intratumoral Pt concentration at the end of perfusion after 90 min (in ng/mg wet tissue)
Endpoint(s): Toxicity evaluation (CTCAE 5.0), Pt concentration in normal tissue (in ng/mg wet tissue), Pt concentration in tumor tissue after 30 min and 60 min of perfusion (in ng/mg wet tissue), Concentration versus time curve and AUC of intra-peritoneal Pt during perfusion, Cmax, tmax, terminal t ½ in perfusate, clearance from perfusate at the end of perfusion, Recurrence-free survival (RFS) and Overall survival (OS)

Source: https://euclinicaltrials.eu/ctis-public/view/2024-514711-99-00